EU clinical trial 2022-503024-27-00: (22267) A parallel-group, randomized, prospective, interventional, double-blind, multicenter global Phase 3 study to investigate the efficacy and safety of finerenone versus placebo, in addition to standard of care, in participants with chronic kidney disease and type 1 diabetes
Protocol code: 22267
Sponsor: Bayer AG (Pharmaceutical company). Phase: Therapeutic confirmatory (Phase III). Countries: Italy (ended), Germany (ended), Denmark (ended), Spain (ended).
Therapeutic area(s): Diseases [C] - Cardiovascular Diseases [C14]
Gender: Female, Male. Age: 18-64 years, 65+ years. Enrolment: 105.
Status: Ended. Start date (EU): 2024-02-27. End date (EU): 2025-09-15. End date: 2025-09-16. Decision date: 2023-10-12. Results received: No. Last updated: 2025-09-25.
Decision dates by country: DE: 2023-10-16, ES: 2023-10-16, DK: 2023-10-12, IT: 2023-10-16

Condition(s): Chronic kidney disease associated with type 1 diabetes mellitus
Product: Finerenone, BAY 94-8862, placebo equal to test product except active substance

Primary endpoint: Change in UACR from baseline (ratio to baseline) over 6 months
Endpoint(s): Number of participants with TEAEs, TESAEs and Hyperkalaemia (AESI)

Source: https://euclinicaltrials.eu/ctis-public/view/2022-503024-27-00